EU clinical trial 2022-500007-52-00: A study comparing exposure of semaglutide and dapagliflozin dosed orally as mono-components versus in a fixed-dose combination
Protocol code: NN9917-4751
Sponsor: Novo Nordisk A/S (Pharmaceutical company). Phase: Human Pharmacology (Phase I)- Bioequivalence Study. Countries: Germany (ended).
Therapeutic area(s): Diseases [C] - Nutritional and Metabolic Diseases [C18]
Gender: Female, Male. Age: 18-64 years. Enrolment: 138.
Status: Ended. Start date (EU): 2022-06-14. End date (EU): 2023-04-13. Decision date: 2022-06-02. Results received: Yes. Last updated: 2023-04-17.
Decision dates by country: DE: 2022-08-25

Condition(s): Diabetes Mellitus, Type 2
Product: Semaglutide D 9 mg, Forxiga 10 mg film-coated tablets, Semaglutide D 4 mg, Semaglutide/dapagliflozin A 9/10 mg, Semaglutide D 1.5 mg, Semaglutide/dapagliflozin A 4/10 mg, Semaglutide/dapagliflozin A 1.5/10 mg

Primary endpoint: AUC(0-24h,sema,ss): area under the semaglutide plasma concentration−time curve during a dosing interval (0 to 24 hours) at steady state, AUC(0-24h,dapa,ss): area under the dapagliflozin plasma concentration−time curve during a dosing interval (0 to 24 hours) at steady state
Endpoint(s): Cmax,(sema,ss): maximum observed semaglutide plasma concentration during a dosing interval (0 to 24 hours) at steady state, Cmax,(dapa,ss): maximum observed dapagliflozin plasma concentration during a dosing interval (0 to 24 hours) at steady state, tmax,(sema,ss): time to maximum observed semaglutide plasma concentration during a dosing interval (0 to 24) at steady state, tmax,(dapa,ss): time to maximum observed dapagliflozin plasma concentration during a dosing interval (0 to 24 hours) at steady state

Source: https://euclinicaltrials.eu/ctis-public/view/2022-500007-52-00